EU clinical trial 2024-518530-92-00: A Phase II study of intratumoral administration of L19IL2/L19TNF in non-melanoma skin cancer patients with presence of injectable lesions.
Protocol code: PHL19IL2TNFNMSC04/19
Sponsor: Philogen S.p.A. (Pharmaceutical company). Phase: Therapeutic exploratory (Phase II). Countries: Poland (ended), Germany (ended).
Therapeutic area(s): Diseases [C] - Neoplasms [C04]
Gender: Female, Male. Age: 18-64 years, 65+ years. Enrolment: 78.
Status: Ended. Start date (EU): 2024-12-09. End date (EU): 2025-10-16. End date: 2025-10-17. Decision date: 2024-11-15. Results received: No. Last updated: 2025-06-24.
Decision dates by country: DE: 2024-11-15, PL: 2024-12-09

Condition(s): Patients with high-risk, locally advanced (non-metastatic, node negative, single or multifocal), Basal Cell Carcinoma (BCC) or cutaneous Squamous Cell Carcinoma (cSCC) amenable to intratumoral injection, not eligible to surgery or radiation therapy according to the evaluation of a local interdisciplinary tumor board or who refuse surgery or radiation therapy and for whom a histological evaluation is available according to international guidelines.
Product: Darleukin, Fibromun

Primary endpoint: Efficacy of L19IL2/L19TNF measured as: Confirmed Best Overall Response Rate (BORR) [Complete Response (CR) + Partial Response (PR)] for BCC tumor type measured according to Response Evaluation Criteria in Solid Tumors (RECIST) v1.1 criteria. Confirmation of CR requires histopathological analysis of exeresis specimens for lesions removed by surgery or of biopsies in all other cases.
Endpoint(s): Efficacy of L19IL2/L19TNF measured as: o Disease Control Rate (DCR) [Complete Response (CR) + Partial Response (PR) + Stable Disease (SD)] for each tumor type measured according to RECIST v1.1 criteria. o Progression-Free Survival (PFS), assessed separately in patients who are not resected after curative intention and in patients who undergo secondary surgery (neoadjuvant intention), whatever the RECIST response to treatment, taking into account appearance of new lesions and occurrence of metast, Safety of intratumoral administration of L19IL2/L19TNF.

Source: https://euclinicaltrials.eu/ctis-public/view/2024-518530-92-00